EU clinical trial 2023-507376-50-00: A Phase 1b, Randomized, Placebo-Controlled, Double-Blind Study to Evaluate Safety, Engraftment, and Initial Signs of Clinical Activity of MB310 in Patients with Active, Mild to Moderate Ulcerative Colitis (COMPOSER-1)
Protocol code: MB310-01
Sponsor: Microbiotica Limited (Pharmaceutical company). Phase: Human Pharmacology (Phase I)- First administration to humans. Countries: Austria (ended), Poland (ended), Bulgaria (ended), Spain (ended).
Therapeutic area(s): Diseases [C] - Digestive System Diseases [C06]
Gender: Female, Male. Age: 18-64 years, 65+ years. Enrolment: 46.
Status: Ended. Start date (EU): 2024-09-27. End date (EU): 2026-01-08. End date: 2026-01-09. Decision date: 2024-08-13. Results received: No. Last updated: 2025-08-11.
Decision dates by country: AT: 2024-08-19, PL: 2024-08-13, ES: 2024-11-27, BG: 2024-08-16

Condition(s): Ulcerative Colitis

Source: https://euclinicaltrials.eu/ctis-public/view/2023-507376-50-00